EU clinical trial 2025-522796-28-00: A Multicenter, Prospective, Randomized, Open-label Phase 2b Study, with Blinded Evaluation, Comparing the Combination of Amodiaquine and Potassium Canrenoate with Either Exenatide or Glibenclamide Versus Best Medical Therapy, in Patients with Acute Ischemic Stroke
Protocol code: GEN-100
Sponsor: Genesis Pharma S.A. (Pharmaceutical company). Phase: Therapeutic exploratory (Phase II). Countries: Greece (not authorised).
Therapeutic area(s): Diseases [C] - Nervous System Diseases [C10]
Gender: Female, Male. Age: 18-64 years, 65+ years. Enrolment: 150.
Status: Not authorised. Decision date: 2026-02-12. Results received: No. Last updated: 2026-02-12.

Condition(s): Acute Ischemic Stroke
Product: Exenatide 3.5μg/mL solution for subcutaneous injection, Potassium canrenoate 5mg/mL solution for intravenous injection, Amodiaquine+Glibenclamide (10mg+0.1mg) /5mL oral suspension, Amodiaquine 2mg/mL solution for intravenous injection, Potassium canrenoate 25mg/5mL oral suspension

Primary endpoint: Percentage of patients with hemorrhagic transformation as depicted in a CT or MRI.
Endpoint(s): Degree of disability based on the mRS score, • Infarct volume defined as MRI lesion volume on Day 5 • Infarct volume defined as MRI lesion volume on Day 90 • Change in DWI lesion volume from Day 5 to Day 90, based on MRI • Change in PWI lesion volume from Day 5 to Day 90, based on MRI, Change in recanalization of the occluded vessel based on MR angiography (MRA)., Percentage of patients with clinically meaningful improvement in NIHSS score (improvement >4 points)., • Percentage of patients treated with investigational combination therapy on top of BMT and those treated with BMT only, experiencing all-cause on-treatment AEs, analyzed for: o patients that complete the study period, and o patients who discontinue from the study period due to an AE. • Percentage of patients with abnormal clinically significant laboratory test results., All-cause mortality., • Percentage of patients who developed depression, defined as score >10 on the HAM-D17 • Percentage of patients who developed mild to moderate depression (HAM-D17 score: 14-17), or moderate to severe depression (HAM-D17 score: >17)., Percentage of change in blood biomarkers., • Observed plasma concentration • Minimum observed plasma concentration at steady state conditions, Correlation of plasma concentrations of the investigational combination treatments with: • The percentage of patients experiencing overall AEs and specific AEs • Degree of disability based on the mRS score • The percentage of patients who developed depression • The percentage of patients with clinically meaningful improvement in NIHSS score • MRI response parameters • Biomarker levels • Treatment compliance

Source: https://euclinicaltrials.eu/ctis-public/view/2025-522796-28-00